EU clinical trial 2025-522857-20-00: An open label, phase I/II study investigating the safety and efficacy of the bispecific T-cell engaging antibody cizutamig (BCMAxCD3) in patients with immune-mediated inflammatory diseases – the SPLENDID Trial
Protocol code: TMP-23062025-2
Sponsor: Fraunhofer Institute For Translational Medicine And Pharmacology ITMP (Laboratory/Research/Testing facility). Phase: Phase I and Phase II (Integrated)- Other. Countries: Germany (ongoing, recruiting).
Therapeutic area(s): Diseases [C] - Immune System Diseases [C20]
Gender: Female, Male. Age: 18-64 years, 65+ years. Enrolment: 12.
Status: Ongoing, recruiting. Start date (EU): 2026-01-22. Decision date: 2025-11-28. Results received: No. Last updated: 2025-11-28.

Condition(s): Severe, treatment refractory primary Sjögren’s disease (pSjD), Severe, treatment refractory idiopathic inflammatory myopathy (IIM), Severe, treatment refractory systemic sclerosis (SSc), Severe, treatment-refractory, seropositive (anti-citrullinated protein antibody (ACPA) and/or rheumatoid factor positive) rheumatoid arthritis (RA)
Product: Cizutamig

Primary endpoint: Primary endpoint (Safety): Incidence and grading of severity of Cytokine Release Syndrome (CRS), Immune Cell Associated Neurotoxicity Syndrome (ICANS) and treatment-emergent adverse events (TEAE) and serious adverse events (SAE) due to IMP until 28 days after the last administration of BCMAxCD3 TCE cizutamig
Endpoint(s): Main disease specific clinical efficacy (SSc): rCRISS30/5 response at Week 16, Main disease specific clinical efficacy (IIM): moderate or major total improvement score (TIS) response at week 16, Main disease specific clinical efficacy (pSjD): change from baseline in European Alliance of Associations for Rheumatology (EULAR) Sjögren's syndrome disease activity index (ESSDAI) at week 16, Main disease specific clinical efficacy (RA): American College of Rheumatology (ACR) 20 response at week 16, Main disease specific clinical efficacy (ONLY for those with interstitial lung disease [ILD] at baseline for all IMIDs): Change in forced vital capacity (FVC) and diffusion capacity of the lungs for carbon monoxide (DLCO) at 16 and 52 weeks compared to baseline, Further disease specific clinical efficacy (SSc): rCRISS 20/30/50 response at week 16 and 52, Further disease specific clinical efficacy (SSc): Change in modified Rodnan skin score (mRSS) at 16, 24 and 52 weeks compared to baseline, Further disease specific clinical efficacy (SSc): Change in Troponin T levels at 16, 24 and 52 weeks compared to baseline, Further disease specific clinical efficacy (SSc): Change in EULAR SSc Impact Score (Sclero-ID) over time compared to baseline, Further disease specific clinical efficacy (SSc): Change in digital ulcer count at 16, 24 and 52 weeks compared to baseline, Further disease specific clinical efficacy (IIM): Minimal, moderate or major TIS response at 16, 24 and 52 weeks, Further disease specific clinical efficacy (IIM): Change in TIS score from baseline at 16, 24 and 52 weeks, Further disease specific clinical efficacy (IIM): Change in muscle memory test 8 (MMT8) at 16, 24 and 52 weeks compared to baseline, Further disease specific clinical efficacy (IIM): Change in physician’s global assessment of extramuscular activity at 16, 24 and 52 weeks compared to baseline, Further disease specific clinical efficacy (IIM): Change in cutaneous disease area and severity index (CDASI) at 16, 24 and 52 weeks (in case of DM) compared to baseline, Further disease specific clinical efficacy (IIM): Change in CK, aldolase and Troponin T levels over time compared to baseline, Further disease specific clinical efficacy (pSjD): Change from baseline in ESSDAI at week 24 and 52, Further disease specific clinical efficacy (pSjD): Change from baseline in EULAR Sjögren’s syndrome patient reported index (ESSPRI) at week 16, 24 and 52, Further disease specific clinical efficacy (pSjD): Percentage (%) of participants with decrease in ESSPRI ≥1 or 15% from baseline at 16, 24 and 52 weeks, Further disease specific clinical efficacy (pSjD): Percentage (%) of participants with decrease in ESSDAI ≥3 points from baseline at 16, 24 and 52 weeks, Further disease specific clinical efficacy (pSjD): Percentage (%) of participants with ESSDAI <5 at 16, 24 and 52 weeks, Further disease specific clinical efficacy (pSjD): Change from baseline in oral and ocular dryness numerical rating scale (NRS) at 16 and 52 weeks, Further disease specific clinical efficacy (pSjD): Percentage (%) of participants with increase of Schirmer's test ≥ 5 mm if abnormal baseline at 16 and 52 weeks, Further disease specific clinical efficacy (RA): American College of Rheumatology (ACR) 50/70 response at 16, 24 and 52 weeks., Further disease specific clinical efficacy (RA): ACR 20 response at week 24 and 52 weeks., Further disease specific clinical efficacy (RA): Disease acitivity score 28 (DAS28)-CRP / DAS28-ESR / simplified disease acitivity index (SDAI) / Boolean remission at 16, 24, and 52 weeks., Further disease specific clinical efficacy (RA): Proportion of patients with DAS28-CRP<3.2 at week 16, 24 and 52, Further disease specific clinical efficacy (RA): Change in DAS28-CRP / SDAI / clinical disease activity index (CDAI) at 16, 24, and 52 weeks compared to baseline., Further disease specific clinical efficacy (RA): Change in ESR values over time compared to baseline, General clinical response and patient reported outcomes in all IMID groups: Duration without disease-modifying antirheumatic drug (DMARD) therapy from week 5 to week 52, General clinical response and patient reported outcomes in all IMID groups: Time until clinical relapse or flare observed between week 5 and week 52, General clinical response and patient reported outcomes in all IMID groups: Number of flares from week 5 through week 52, General clinical response and patient reported outcomes in all IMID groups: Cumulative steroid dosage from week 5 to week 52, General clinical response and patient reported outcomes in all IMID groups: Change in levels of CRP over time compared to baseline, General clinical response and patient reported outcomes in all IMID groups: Change in hand strength over time compared to baseline, General clinical response and patient reported outcomes in all IMID groups: Change in patient’s global assessment (PtGA) of disease activity (VAS 0-100mm) over time compared to baseline, General clinical response and patient reported outcomes in all IMID groups: Change in physician’s global assessment (PhGA) of disease activity (VAS 0-100mm) over time compared to baseline, General clinical response and patient reported outcomes in all IMID groups: Change in Functional Assessment of Chronic Illness Therapy - Fatigue (FACIT-F) over time compared to baseline, General clinical response and patient reported outcomes in all IMID groups: Change in Short Form 36 (SF-36, quality of life questionnaire) over time compared to baseline, General clinical response and patient reported outcomes in all IMID groups: Change in Health Assessment Questionnaire Disability Index (HAQ-DI) over time compared to baseline

Source: https://euclinicaltrials.eu/ctis-public/view/2025-522857-20-00